EU clinical trial 2024-515180-56-00: A Phase 3, Multi-Center, Randomized, Single-Blind Study to Assess the Efficacy and Safety of Cefepime/Nacubactam and Aztreonam/Nacubactam Versus Best Available Therapy in Adults With Complicated Urinary Tract Infection, Acute Uncomplicated Pyelonephritis, Hospital-Acquired Bacterial Pneumonia, Ventilator-Associated Bacterial Pneumonia, and Complicated Intra-Abdominal Infection due to Carbapenem Resistant Enterobacterales (OP0595-6)
Protocol code: OP0595-6
Sponsor: Meiji Seika Pharma Co. Ltd. (Pharmaceutical company). Phase: Therapeutic confirmatory (Phase III). Countries: France (ended), Czechia (ended), Greece (ended), Slovakia (ended), Latvia (ended), Croatia (ended), Spain (ended).
Therapeutic area(s): Diseases [C] - Bacterial Infections and Mycoses [C01]
Gender: Female, Male. Age: 18-64 years, 65+ years. Enrolment: 96.
Status: Ended. Start date (EU): 2023-06-26. End date (EU): 2025-09-01. End date: 2026-03-02. Decision date: 2024-08-22. Results received: Yes. Last updated: 2025-06-17.
Decision dates by country: HR: 2024-08-26, CZ: 2024-08-23, FR: 2024-08-27, GR: 2024-08-26, LV: 2024-08-22, SK: 2024-08-23, ES: 2024-08-26

Condition(s): Complicated urinary tract infection (cUTI), acute uncomplicated pyelonephritis (AP), hospital acquired bacterial pneumonia (HABP), ventilator-associated bacterial pneumonia (VABP), and complicated intra-abdominal infection (cIAI)
Product: IMIPENEM, CILASTATIN AND RELEBACTAM, AMIKACIN, TIGECYCLINE, Nacubactam, AZACTAM 1 g, poudre et solution pour usage parentéral, COLISTIN, Cefepime Panpharma, 2 g, proszek do sporządzania roztworu do wstrzykiwań lub infuzji

Primary endpoint: The primary efficacy endpoint is the proportion of patients with overall treatment success at TOC across all infection types (ie, cUTI, AP, HABP, VABP, and cIAI), which is a composite endpoint derived from the efficacy outcomes of each infection type. This is the proportion of patients in the Microbiological CRE Modified Intent to-Treat (mCRE-MITT) Population with a treatment outcome of success.
Endpoint(s): Secondary efficacy endpoints across all infection types, for individual infection type and across all infection types, for cUTI/AP only, for HABP/VABP only, or cIAI only, for secondary bacteremia only are included in study protocol

Source: https://euclinicaltrials.eu/ctis-public/view/2024-515180-56-00